EU clinical trial 2022-501576-25-00: A Phase 3 Trial of Fianlimab (anti-LAG-3) and Cemiplimab versus Pembrolizumab in the Adjuvant Setting in Patients with Completely Resected High-risk Melanoma
Protocol code: R3767-ONC-2055
Sponsor: Regeneron Pharmaceuticals Inc. (Pharmaceutical company). Phase: Therapeutic confirmatory (Phase III). Countries: Czechia (ongoing, recruitment ended), Belgium (ongoing, recruitment ended), France (ongoing, recruitment ended), Romania (ongoing, recruitment ended), Ireland (ongoing, recruitment ended), Italy (ongoing, recruitment ended), Spain (ongoing, recruitment ended), Greece (ongoing, recruitment ended), Germany (ongoing, recruiting), Poland (ongoing, recruiting).
Therapeutic area(s): Diseases [C] - Neoplasms [C04]
Gender: Female, Male. Age: 0-17 years, 18-64 years, 65+ years. Enrolment: 798.
Start date (EU): 2023-07-07. Decision date: 2023-05-29. Results received: No. Last updated: 2026-07-06.
Decision dates by country: IE: 2023-05-31, BE: 2023-05-30, FR: 2023-05-30, PL: 2023-05-31, IT: 2023-05-31, CZ: 2023-05-30, ES: 2023-05-29, RO: 2023-05-31, GR: 2023-05-31, DE: 2023-05-31

Condition(s): Melanoma
Product: KEYTRUDA 25 mg/mL concentrate for solution for infusion, Fianlimab, LIBTAYO 350 mg concentrate for solution for infusion.

Primary endpoint: Relapse free survival (RSF)
Endpoint(s): Overall survival (OS), Distant metastasis-free survival (DMFS), Occurrence of treatment-emergent adverse events (TEAEs), Occurrence of immune-mediated EAEs (im-EAEs), Occurrence of serious adverse events (SAEs), Occurrence of adverse events of special interest (AESIs), Occurrence of TEAEs resulting in death, Occurrence of dose-limiting toxicity (DLT), Occurrence of interruption or discontinuation of study drug(s) due to TEAE, Occurrence of laboratory abnormalities, Concentrations of fianlimab in serum over time, Concentrations of cemiplimab in serum over time, Concentration of finalimab anti-drug antibodies (ADA) and neutralizing antibodies, Concentration of cemiplimab anti-drug antibodies (ADA) and neutralizing antibodies, Patient report outcomes (PRO) for adults as measured by the European Organization for Research and Treatment of Cancer Quality of Life Questionnaire C30 (EORTC-QLQ-C30), PRO for adults as measured by the European Quality of Life Dimension 5 (EQ-5D-5L), PRO for adults as measured by the Functional Assessment of Cancer Therapy (FACT) - melanoma, PRO for adults as determined by the Patient Global Impressions Scale (PGIS), PRO for adults as determined by the Patient Global Impressions of Change Scale (PGIC), Time to global health status/quality of life deterioration per EORTC QLQ-C30, Time to physical functioning deterioration per EORTC QLQ-C30, Time to role functioning deterioration per EORTC QLQ-C30

Source: https://euclinicaltrials.eu/ctis-public/view/2022-501576-25-00